EU clinical trial 2024-516659-41-00: “A phase II randomized non-comparative study, with NEOadjuvant plus adjuvant Therapy with combination or sequence of vemurafenib, cobImetinib, and atezolizuMab in patients with high-risk, surgically resectable BRAF mutated and wild-type Melanoma”
Protocol code: NEO-TIM
Sponsor: Fondazione Melanoma Onlus (Laboratory/Research/Testing facility). Phase: Therapeutic exploratory (Phase II). Countries: Italy (ongoing, recruiting).
Therapeutic area(s): Diseases [C] - Neoplasms [C04]
Gender: Female, Male. Age: 18-64 years, 65+ years. Enrolment: 94.
Status: Ongoing, recruiting. Start date (EU): 2020-10-12. Decision date: 2024-09-30. Results received: No. Last updated: 2026-07-28.

Condition(s): high-risk, surgically resectable BRAF mutated and wild-type Melanoma
Product: VEMURAFENIB, ATEZOLIZUMAB, COBIMETINIB

Primary endpoint: The primary objective is to determine the pathologic complete response (pCR) rate. (Centrally/Independently determined). Pathologic complete response, which is defined as residual cancer burden 0.
Endpoint(s): Recurrence-Free Survival (RFS) at 2-years, 3-years and at the end of the study. RFS defined as the time from randomisation to recurrence event (local or distant disease development, or death). For patients without events at the end of the study time will be censored at the date of last follow-up., Overall Survival (OS) defined as the time from randomisation to death. For patients alive at the end of the study time will be censored at the date of last follow-up., Pathological Overall Response rate (pORR) defined as the sum of pathologic complete responses (pCRs), near pathologic complete responses (near pCRs) and pathologic partial responses (pPRs)., Safety, To determine molecular and immunophenotypic changes in tumour and peripheral blood evaluating several biomarkers.

Source: https://euclinicaltrials.eu/ctis-public/view/2024-516659-41-00